EU clinical trial 2025-522133-66-00: Immunomodulatory therapy to restore ovarian function and improve fertility in women with autoimmune premature ovarian insufficiency – a double-blind, placebo-controlled, randomized study
Sponsor: Karolinska University Hospital (Hospital/Clinic/Other health care facility). Phase: Therapeutic confirmatory (Phase III). Countries: Sweden (authorised, recruitment pending).
Therapeutic area(s): Diseases [C] - Female Urogenital Diseases and Pregnancy Complications [C13]
Gender: Female. Age: 18-64 years. Enrolment: 30.
Status: Authorised, recruitment pending. Decision date: 2025-10-17. Results received: No. Last updated: 2025-10-17.

Condition(s): Autoimmune Premature Ovarian Insufficiency
Product: RITUXIMAB

Primary endpoint: Egg retrieval (yes/no) in response to controlled ovarian hyperstimulation at 4 to 6 months post-rituximab treatment compared to placebo, as well as within the rituximab-treated group at 4 to 6 and 12 months after the last treatment session compared to baseline.
Endpoint(s): Occurrence of spontaneous menstrual bleeding (yes/no) at any point during the 19-month study period., Proportion of participants who achieve ovulation (defined as serum progesterone >10 nmol/L) at any time during the study period., Changes in B-cell count, auto-antibody indices, and immunoglobulin (IgG) levels from baseline to the end of the study period., Changes in serum follicle-stimulating hormone (FSH) and anti-Müllerian hormone (AMH) levels from baseline to the end of the study period., Changes in quality of life scores, as measured by validated instruments (AddiQol, PGWB, SF-36, and MRS), from baseline to the end of the study period., Safety endpoint: the incidence and severity of adverse events, hospital admissions, infections, allergic reactions and over stimulation in relation to the controlled ovarian hyperstimulation.

Source: https://euclinicaltrials.eu/ctis-public/view/2025-522133-66-00